EU clinical trial 2023-504949-31-00: A study to investigate the safety and tolerability of Trastuzumab Deruxtecan in combination with Immunotherapy Agents with and without chemotherapy, as the first treatment option for patients with advanced HER2 over-expressing Non-Small Cell Lung Cancer.
Protocol code: D967YC00001
Sponsor: AstraZeneca AB (Pharmaceutical company). Phase: Human Pharmacology (Phase I)- Other. Countries: Poland (ongoing, recruiting), Italy (ongoing, recruiting), France (ongoing, recruiting).
Therapeutic area(s): Diseases [C] - Neoplasms [C04]
Gender: Female, Male. Age: 18-64 years, 65+ years. Enrolment: 52.
Status: Ongoing, recruiting. Start date (EU): 2021-12-01. Decision date: 2024-11-14. Results received: No. Last updated: 2026-04-30.
Decision dates by country: PL: 2024-11-16, FR: 2024-11-14, IT: 2024-11-19

Condition(s): Advanced or metastatic non-squamous non-small lung cancer (mNSCLC) with human epidermal growth factor receptor 2 (HER2) overexpression (OE)

Source: https://euclinicaltrials.eu/ctis-public/view/2023-504949-31-00